EU clinical trial 2025-522742-46-00: CANIDIAP; CANagliflozin In DIAlysis Patients
Protocol code: 20725
Sponsor: Universitair Medisch Centrum Groningen (Hospital/Clinic/Other health care facility). Phase: Therapeutic use (Phase IV). Countries: Netherlands (authorised, recruitment pending).
Therapeutic area(s): Not possible to specify
Gender: Female, Male. Age: 18-64 years, 65+ years. Enrolment: 10.
Status: Authorised, recruitment pending. Decision date: 2026-02-23. Results received: No. Last updated: 2026-02-23.

Condition(s): Chronic Kidney disease
Product: 18F-Canagliflozin, Invokana 300 mg film-coated tablets

Primary endpoint: The overall percentage of receptor occupancy.
Endpoint(s): The percentage of receptor occupancy in the specific regions of interest., The overall percentage of receptor occupancy compared between dialysis patients that have and that do not have residual diuresis.

Source: https://euclinicaltrials.eu/ctis-public/view/2025-522742-46-00